EU clinical trial 2024-517054-94-00: RANDOMISED DOUBLE-BLIND PLACEBO-CONTROLLED PHASE 3 TRIAL OF TRIUMEQ IN AMYOTROPHIC LATERAL SCLEROSIS - LIGHTHOUSE II
Sponsor: Stichting TRICALS Foundation (Laboratory/Research/Testing facility). Phase: Therapeutic confirmatory (Phase III). Countries: Sweden (ended), Netherlands (ended), Spain (ended), Slovenia (ended), Ireland (ended).
Therapeutic area(s): Phenomena and Processes [G] - Musculoskeletal and Neural Physiological Phenomena [G11]; Diseases [C] - Nervous System Diseases [C10]
Gender: Female, Male. Age: 18-64 years, 65+ years. Enrolment: 119.
Status: Ended. Start date (EU): 2021-07-05. End date (EU): 2025-03-26. Decision date: 2024-12-03. Results received: Yes. Last updated: 2024-12-04.
Decision dates by country: IE: 2024-12-03, SI: 2024-12-03, ES: 2024-12-04, SE: 2024-12-04, NL: 2024-12-03

Condition(s): AMYOTROPHIC LATERAL SCLEROSIS
Product: The placebo capsules have a formulation that matches crushed Triumeq tablets regarding appearance and taste., Triumeq 50 mg/600 mg/300 mg film-coated tablets

Primary endpoint: The primary endpoint is overall survival, defined as time to mortality from any cause
Endpoint(s): Combined assessment of survival and measures of daily functioning using the ALSFRS-R(30) total score (CAFS), Daily functioning using the ALSFRS-R(30) total score, Respiratory function measured by vital capacity (VC) (% predicted of normal according to the GLI-2012 reference standard(37)), Plasma creatinine levels, Clinical disease stage, defined as mean time spent in each stage of the King’s Staging Scale and the ALS Milano-Torino staging systems (36) (MITOS, derived from ALSFRS-R(30)), Safety based on the safety assessments including physical examinations, clinical laboratory evaluations, vital signs and frequency of adverse events (AEs) or serious adverse events (SAEs). (S)A Es will be categorized according seriousness, causality (by study medication), severity and expectedness (as defined in the Triumeq Summary of Product Characteristics), Tolerabilty, as defined by study medication discontinuation, Cognitive function, defined as the total scores on the ECAS(32), Quality of life, defined as total scores on the Visual Analogue Scale (single-item scale) and EQ-5D-5L(35), Laboratory parameters e.g. Urine P75ECD, plasma neurofilament light and heavy chain, HERV-K expression and genotyping (UNC13a / C9orf72)

Source: https://euclinicaltrials.eu/ctis-public/view/2024-517054-94-00